EU clinical trial 2026-526270-17-00: Early switch to oral antibiotic therapy in vertebral osteomyelitis: a multicentre, open-label, randomised, active control, parallel group, non-inferiority trial (sWITCH-VO)
Protocol code: Uni-Koeln-5780
Sponsor: University Of Cologne (Educational Institution). Phase: Therapeutic use (Phase IV). Countries: Germany (authorised, recruitment pending).
Therapeutic area(s): Diseases [C] - Musculoskeletal Diseases [C05]; Diseases [C] - Bacterial Infections and Mycoses [C01]
Gender: Female, Male. Age: 18-64 years, 65+ years. Enrolment: 280.
Status: Authorised, recruitment pending. Decision date: 2026-07-09. Results received: No. Last updated: 2026-07-09.

Condition(s): bone and joint infections
Product: AMOXICILLIN, CEFADROXIL, AMOXICLAV BASICS 875 mg/125 mg Filmtabletten, DOXYCYCLINE, RIFAMPICIN, PHENOXYMETHYLPENICILLIN, CIPROFLOXACIN, METRONIDAZOLE, MOXIFLOXACIN, CLINDAMYCIN, CEFALEXIN, FLUCLOXACILLIN, LEVOFLOXACIN, LINEZOLID, Co-Trimoxazole Forte 160/800mg Tablets

Primary endpoint: Composite clinical failure endpoint assessed 24 weeks after cessation of antibiotic therapy, including: - All-cause mortality - Unplanned spine-related surgery for VO - Relapse of bacteraemia with the primary pathogen - Relapse of bacteria with the initial pathogen being cultured from material from infected areas in relation to the spine or iliopsoas muscle - Renewed IV antibiotic therapy for >7 days for treatment of VO
Endpoint(s): Quality of life, measured by patient-reported outcome measures (PROMs) using the Oswestry Disability Index (ODI), Occurrence of each component of the composite primary endpoint, Duration of hospital stay, Occurrence of readmission, Early termination of allocated treatment strategy due to adverse events, patient preference, or any other reason, Complications related to IV treatment, Incidence of Clostridioides difficile–associated diarrhoea, Quality of life measured by EQ-5D-5L, Functional status and activities of daily living (CFS, Barthel Index), Ability to work, Patient-reported experience measures (PREMs), Additional IV antibiotic therapy exceeding 5 days for any reason, Occurrence of severe adverse events related to antibiotic treatment

Source: https://euclinicaltrials.eu/ctis-public/view/2026-526270-17-00